EU clinical trial 2023-505471-78-00: PET study of changes in [11C]AZ14132516 uptake following administration of AZD7798 to healthy participants and patients with Crohn’s disease
Protocol code: D9690C00004
Sponsor: Astrazeneca AB (Pharmaceutical company). Phase: Human Pharmacology (Phase I)- Other. Countries: Sweden (ended).
Therapeutic area(s): Diseases [C] - Digestive System Diseases [C06]
Gender: Female, Male. Age: 18-64 years, 65+ years. Enrolment: 14.
Status: Ended. Start date (EU): 2023-09-25. End date (EU): 2024-10-08. Decision date: 2023-08-31. Results received: No. Last updated: 2024-05-22.

Condition(s): Crohn's Disease

Source: https://euclinicaltrials.eu/ctis-public/view/2023-505471-78-00